EU clinical trial 2024-517861-18-00: Early start corticosteroids versus standard care (RASBs followed by corticosteroids) for proteinuria in Immunoglobulin A Nephropathy (IgAN) patients with active renal lesions identified by kidney biopsy and RASBs combined with corticosteroids versus sodium-glucose cotransporter2 inhibitor combined with RASBs for proteinuria and renal function in IgAN patients with chronic renal lesions identified by kidney biopsy. A PROJECT FOR TWO MULTICENTRE, PROSPECTIVE OPEN LABEL RANDOMIZED CLINICAL STUDIES TO EVALUATE THE EFFECT OF TARGETED THERAPY BASED ON KIDNEY BIOPSY FINDINGS IN IgAN PATIENTS (CLIgAN)
Sponsor: Fondazione Schena Centro Europeo Della Ricerca Sulle Malattie Renali (Laboratory/Research/Testing facility). Phase: Therapeutic confirmatory (Phase III). Countries: Italy (authorised, recruitment pending).
Therapeutic area(s): Diseases [C] - Immune System Diseases [C20]
Gender: Female, Male. Age: 18-64 years, 65+ years. Enrolment: 432.
Status: Authorised, recruitment pending. Decision date: 2024-10-16. Results received: No. Last updated: 2025-07-10.

Condition(s): Idiopathic IgA nephropathy (IgAN)
Product: PREDNISONE, DAPAGLIFLOZIN, RAMIPRIL, SOLU MEDROL 1000 mg/15,6 ml polvere e solvente per soluzione iniettabile, LOSARTAN

Primary endpoint: Between-arms difference in proteinuria reduction within 4 months and in nonresponders within 8 months in ACIgAN study., Between-arms difference in proteinuria reduction within 10 months in CHRONIgAN study.
Endpoint(s): eGFR slope calculated as mean of individual slope obtained from individual linear regression of eGFR overtime (3 years);, eGFR decline > 40 % from the baseline value;, composite end point: GFR decline > 40%, ESKD (defined as long-term GFR <= 15 ml/min/1.73m2 for more than three months or need for maintenance dialysis or kidney transplantation) or death due to kidney disease;, absolute difference between last GFR value and baseline GFR;, stable renal function defined as a decline in GFR <= 5 ml/min/1.73m2 at the end of three years follow- up, mean annual change in the slope of the reciprocal of serum creatinine concentration;, time-averaged proteinuria (TA-P) calculated as the weighted mean of all postrandomisation measurement, with weights representing the time elapsed since the previous measurement;, proteinuria slope, calculated as a mean of individual slope, obtained from individual linear regression of daily proteinuria overtime (3 years);, complete remission of proteinuria defined as achievement of urinary protein level <= 0.2 g/day or a urinary protein-to-creatinine ratio <= 0.2 g/g;, partial remission of proteinuria defined as achievement of a urinary protein reduction >= 50% or greater compared with the baseline value.

Source: https://euclinicaltrials.eu/ctis-public/view/2024-517861-18-00